EU clinical trial 2024-512856-40-00: A randomized, parallel-group, double-blind, placebo-controlled, multicenter trial to investigate the efficacy and safety of subcutaneously administered secukinumab in patients with new-onset of giant cell arteritis (GCA) who are in clinical remission and eligible for treatment with glucocorticoidmonotherapy (GigAINt)
Protocol code: CAIN457R1DE01
Sponsor: Novartis Pharma GmbH (Pharmaceutical company). Phase: Therapeutic confirmatory (Phase III). Countries: Germany (ended).
Therapeutic area(s): Phenomena and Processes [G] - Immune system processes [G12]
Gender: Female, Male. Age: 18-64 years, 65+ years. Enrolment: 146.
Status: Ended. Start date (EU): 2022-09-21. End date (EU): 2026-02-24. Decision date: 2024-08-26. Results received: No. Last updated: 2026-02-06.

Condition(s): Giant Cell Arteritis
Product: Placebo to AIN457 300 mg/2 mL Solution for injection in pre-filled syringe, Cosentyx 300 mg solution for injection in pre-filled syringe

Primary endpoint: Time from baseline to first GCA clinical relapse
Endpoint(s): Proportion of participants in sustained clinical remission at Week 52, Efficacy endpoints: - Changes from Baseline to Week 52 in disease activity and quality of life for each of the following: PGA score (VAS), SF-36 (PCS and MCS) score, Patient assessment of pain (NRS) and other assessments - Time from Baseline to reach prednisolone or equivalent dose below ≤7.5 mg/day - Proportion of participants on prednisolone or equivalent dose below Cushing threshold of ≤7.5 mg/day at Week 52 - Cumulative prednisolone or equivalent dose through Week 52, Safety and tolerability assessments over time: incidence and severity of AEs and SAEs; routine safety laboratory parameters

Source: https://euclinicaltrials.eu/ctis-public/view/2024-512856-40-00